EU clinical trial 2024-519549-31-00: A Phase 3b, open-label, multi-center study to assess the immune response and safety of the meningococcal group B vaccine rMenB+OMV NZ when administered to healthy participants aged 10 to 20 years old, who were primed during the first 2 years of life
Protocol code: 220030
Sponsor: GlaxoSmithKline Biologicals (Pharmaceutical company). Phase: Therapeutic confirmatory (Phase III). Countries: Italy (ended), Finland (ended), Spain (ended).
Therapeutic area(s): Diseases [C] - Bacterial Infections and Mycoses [C01]
Gender: Female, Male. Age: 0-17 years, 18-64 years. Enrolment: 247.
Status: Ended. Start date (EU): 2025-09-05. End date (EU): 2026-03-24. End date: 2026-03-24. Decision date: 2025-08-11. Results received: No. Last updated: 2025-11-07.
Decision dates by country: IT: 2025-08-12, ES: 2025-08-11, FI: 2025-08-12

Condition(s): Invasive meningococcal disease (IMD)
Product: Bexsero suspension for injection in pre-filled syringe Meningococcal group B Vaccine (rDNA, component, adsorbed), Bexsero suspension for injection in pre-filled syringe Meningococcal group B Vaccine (rDNA, component, adsorbed), Bexsero suspension for injection in pre-filled syringe Meningococcal group B Vaccine (rDNA, component, adsorbed), Bexsero suspension for injection in pre-filled syringe Meningococcal group B Vaccine (rDNA, component, adsorbed)

Primary endpoint: hSBA titers against each MenB indicator strain at Visit 2 (Day 31).
Endpoint(s): hSBA titers against each MenB indicator strain at Visit 2 (Day 31)., hSBA titers against each MenB indicator strain at Visit 1 (Day 1)., • Occurrence of solicited administration site and systemic events within 7 days following the first vaccination. • Occurrence of any unsolicited AEs within 31 days (including the day of injection) following the first vaccination. • Occurrence of AESI (arthritis), SAEs, AEs leading to withdrawal throughout the study period (Day 1 to Day 31).

Source: https://euclinicaltrials.eu/ctis-public/view/2024-519549-31-00